EU clinical trial 2022-503001-38-01: A phase IIIb study to characterize the efficacy and safety of Adjuvant ribociclib plus endocrine therapy in a close-to-clinical practice patient population with HR+ HER2− early breast cancer (Adjuvant WIDER)
Protocol code: CLEE011O12001
Sponsor: Novartis Pharma AG (Pharmaceutical company). Phase: Therapeutic confirmatory (Phase III). Countries: Portugal (ongoing, recruitment ended), Germany (ongoing, recruitment ended).
Therapeutic area(s): Diseases [C] - Neoplasms [C04]
Gender: Female, Male. Age: 18-64 years, 65+ years. Enrolment: 172.
Status: Ongoing, recruitment ended. Start date (EU): 2025-07-08. Decision date: 2025-06-11. Results received: No. Last updated: 2026-07-24.
Decision dates by country: DE: 2025-06-11, PT: 2025-06-20

Condition(s): HR-positive HER-2- negative Breast Cancer
Product: GOSERELIN, RIBOCICLIB, EXEMESTANE, GOSERELIN, LEUPRORELIN ACETATE, LEUPRORELIN ACETATE, LETROZOLE, ANASTROZOLE

Primary endpoint: iBCFS using STEEP Version 2.0 criteria (Standardized Definitions for Efficacy Endpoints in Adjuvant Breast Cancer Clinical Trials), as assessed by Investigator
Endpoint(s): Incidence and severity of adverse events (AEs) using CTCAE v4.03, iDFS utilisant les critères STEEP version 2.0, DRFS using STEEP Version 2.0 criteria, RFI using STEEP Version 2.0 criteria, Relative Dose Intensity (RDI), Overall survival (OS) defined as from the start of treatment to date of death due to any cause., Time to discontinuation (TTD) of ribociclib, Changes from Baseline in FACT-B, FACT-ES, FACIT-F, EQ-5D-5L and WPAI-GH PRO questionnaires, DDFS using STEEP Version 2.0 criteria

Source: https://euclinicaltrials.eu/ctis-public/view/2022-503001-38-01